EU clinical trial 2025-521391-58-00: A Phase 2 Randomized, Double-blind Placebo-Controlled Study to Evaluate the Pharmacokinetics, Immunogenicity, Safety and Efficacy of WIN378 in Adult Participants with Moderate or Severe Asthma (the POLARIS trial)
Protocol code: WB-2101
Sponsor: Windward Bio AG (Pharmaceutical company). Phase: Therapeutic exploratory (Phase II). Countries: Germany (ongoing, recruiting), France (ongoing, recruitment ended), Sweden (ended), Bulgaria (ongoing, recruiting), Spain (ongoing, recruiting).
Therapeutic area(s): Diseases [C] - Respiratory Tract Diseases [C08]
Gender: Female, Male. Age: 18-64 years, 65+ years. Enrolment: 202.
Start date (EU): 2025-11-28. Decision date: 2025-11-10. Results received: No. Last updated: 2026-08-06.
Decision dates by country: SE: 2025-11-10, BG: 2025-11-11, DE: 2025-11-10, ES: 2025-11-12, FR: 2025-11-12

Condition(s): Asthma
Product: Matching placebo for WIN378, WIN378

Primary endpoint: 1. Treatment-emergent adverse events (TEAEs), treatment-emergent serious adverse events (TESAEs), vital signs, laboratory assessments, and electrocardiogram (ECG) during the trial (Week 0 [Day 1] to Week 60)., 2. WIN378 PK and anti-drug antibodies (ADA) during the trial (Week 0 [Day 1] to Week 60).
Endpoint(s): 1. Change from baseline in FeNO at week 24, 2. Change from baseline in FEV1 at Week 24 and Week 48, 3. Change from baseline in FeNO at Week 24 and Week 48, 4. Change from baseline in BEC at Week 24 and Week 48, 5. An exposure-response analysis will be done to support selection of the optimal dose(s) for future testing. The analysis will describe the exposure-response relationship between concentration of WIN378 and change in FeNO, FEV1, and eosinophil count over 48 weeks., 6. Change from baseline in lung function as measured by pre-bronchodilator (BD) and post-BD FEV1 and forced vital capacity (FVC) at Week 24 and Week 48, 7a. Annualized asthma exacerbation rate (AAER), annualized rate of severe asthma exacerbations, time to first asthma exacerbation/severe asthma exacerbation, and proportion of participants without any asthma exacerbations/severe asthma exacerbations over 48 weeks, 7b. Change from baseline in Asthma Quality of Life Questionnaire (Standardised) (AQLQ[S]+12) and European Quality of Life - 5 Dimensions 5 Level Version (EQ-5D-5L) at Week 48, 8. Annualized asthma exacerbation rate (AAER), 9. Change from baseline in pre-bronchodilator forced expiratory volume in 1 second (pre-BD FEV1) at Week 48, 10. Change from baseline in Asthma Control Questionnaire-6 (ACQ-6) score at Week 48 Change from baseline in Asthma Quality of Life Questionnaire (Standardised) for 12 years and older (AQLQ[S]+12) total score at Week 48, 11. Change from baseline in FeNO at Week 48, 12. Change from baseline in BEC at Week 48, 13. Time to first asthma exacerbation Proportion of participants without any asthma exacerbation over 48 weeks Annualized rate of asthma exacerbations associated with emergency room (ER) visit, urgent care visit, or hospitalization, 14. Change from baseline in mean number of occasions of rescue medication use per day over 2 weeks (2-week mean) Change from baseline in morning peak expiratory flow (PEF) (2-week mean) Mean number of days with systemic corticosteroids use due to asthma exacerbation over 48 weeks, 15. WIN378 PK and anti-drug antibody (ADA) formation over the course of the trial, 16. An exposure-response analysis will be done to support selection of the optimal dose(s) for future testing. The analysis will describe the exposure-response relationship between concentration of WIN378 and change in FeNO, FEV1, and eosinophil count over 24 and 48 weeks, 17. Patient Global Impression of Change/Severity (PGI-C, PGI-S) during the 48-week period, 18. European Quality of Life - 5 Dimensions 5 Level (EQ‑5D-5L) score

Source: https://euclinicaltrials.eu/ctis-public/view/2025-521391-58-00